EU clinical trial 2024-518254-16-00: NOPHO-DBH AML 2012 Protocol: Research study for treatment of children and adolescents with acute myeloid leukemia 0-18 years
Sponsor: Vaestra Goetalandsregionen (Hospital/Clinic/Other health care facility). Phase: Therapeutic confirmatory (Phase III). Countries: Finland (ongoing, recruiting), Netherlands (ongoing, recruiting), Belgium (ongoing, recruiting), Sweden (ongoing, recruiting), Spain (ongoing, recruiting), Denmark (ongoing, recruiting), Norway (ongoing, recruiting).
Therapeutic area(s): Diseases [C] - Neoplasms [C04]
Gender: Female, Male. Age: 0-17 years, 18-64 years. Enrolment: 730.
Status: Ongoing, recruiting. Start date (EU): 2013-03-01. Decision date: 2024-11-12. Results received: No. Last updated: 2024-11-22.
Decision dates by country: BE: 2024-11-13, DK: 2024-11-15, FI: 2024-11-13, ES: 2024-11-22, SE: 2024-11-12, NL: 2024-11-15, NO: 2024-11-14

Condition(s): Acute Myeloid Leukemia (Pediatric 0-18 years)
Product: ETOPOSIDE, CYTARABINE, DAUNORUBICIN, DAUNORUBICIN HYDROCHLORIDE, MITOXANTRONE, FLUDARABINE PHOSPHATE

Primary endpoint: The fraction of patients who achieve an MRD level below 0.1%, as quantified by flow cytometry, after the first induction course. (aim 1), The fraction of patients who achieve an MRD level below 0.1%, as quantified by flow cytometry, after the second induction course (aim 2), For patients with fusion genes MRD levels after course 1 and 2 (aim 3)
Endpoint(s): Event-free survival and overall survival at five years, The median MRD after course 1 and course 2., The rate of CR after one and two induction courses., Cardiac function after one and five years., Frequency of severe adverse events as defined in section 14.2.3 in the protocol, early deaths and deaths in CR

Source: https://euclinicaltrials.eu/ctis-public/view/2024-518254-16-00